EU clinical trial 2024-519482-22-00: Phase 1 clinical trial to evaluate the safety, tolerability and pharmacokinetics of multiple daily doses of IM-250 in healthy volunteers.
Protocol code: IM-102
Sponsor: Innovative Molecules GmbH (Pharmaceutical company). Phase: Human Pharmacology (Phase I)- Other. Countries: Bulgaria (ended).
Therapeutic area(s): Not possible to specify
Gender: Female, Male. Age: 18-64 years. Enrolment: 12.
Status: Ended. Start date (EU): 2025-04-30. End date (EU): 2025-06-27. Decision date: 2025-04-23. Results received: No. Last updated: 2025-05-12.

Condition(s): Healthy Volunteers

Source: https://euclinicaltrials.eu/ctis-public/view/2024-519482-22-00